EU clinical trial 2024-514480-26-00: LESS : Single-arm study to de-escalate adjuvant endocrine therapy duration in women with HR+ HER2- breast cancer at very low risk of metastasis
Protocol code: UC-BCG-2103
Sponsor: Unicancer (Hospital/Clinic/Other health care facility). Phase: Therapeutic exploratory (Phase II). Countries: France (ongoing, recruitment ended).
Therapeutic area(s): Diseases [C] - Neoplasms [C04]
Gender: Female. Age: 18-64 years, 65+ years. Enrolment: 776.
Status: Ongoing, recruitment ended. Start date (EU): 2022-10-12. Decision date: 2024-06-05. Results received: No. Last updated: 2025-04-29.

Condition(s): Post-menopausal women with localized luminal A breast cancer and considered at low risk of metastatic relapse
Product: EXEMESTANE, ANASTROZOLE, LETROZOLE

Primary endpoint: Distant relapse–free interval (DRFI) defined as the time from date of beginning of hormonotherapy to the date of first event of distant recurrence or breast cancer related death.
Endpoint(s): Invasive disease-free survival (iDFS), Invasive breast cancer–free survival (iBCFS), Breast cancer specific survival (BCSS), Overall survival (OS), Quality of life, Safety: Adverse Events will be graded according to NCI-CTCAE v5.0, Distant Disease-Free Survival (DDFS)

Source: https://euclinicaltrials.eu/ctis-public/view/2024-514480-26-00